EU clinical trial 2024-515432-71-00: Efficacy of adjuvant Imatinib in patients with intermediate-risk gastrointestinal stromal tumor with a high-risk Genomic Grade Index. Multicenter, prospective, randomized study.
Sponsor: Centre Hospitalier Regional De Marseille (Hospital/Clinic/Other health care facility). Phase: Therapeutic confirmatory (Phase III). Countries: France (ongoing, recruiting).
Therapeutic area(s): Diseases [C] - Digestive System Diseases [C06]
Gender: Female, Male. Age: 18-64 years, 65+ years. Enrolment: 80.
Status: Ongoing, recruiting. Start date (EU): 2016-09-13. Decision date: 2024-07-26. Results received: No. Last updated: 2024-07-26.

Condition(s): gastrointestinal stromal tumor
Product: IMATINIB

Primary endpoint: The efficacy of adjuvant Imatinib defined by the rate of metastatic relapse at 2 years based on a thoraco-abdominal and pelvic CT-scan
Endpoint(s): 1-year, 2-year and 3-year metastasis-free survival based on a thoraco-abdominal and pelvic CT-scan. Metastasis-free survival will be defined as the time from the baseline visit (feedback of the randomization to the patient) and the earliest date of documented radiological occurrence of metastasis., Overall survival, Clinical and biological tolerance, Patients’ quality of life assesssed by a generic questionnaire: the French version of the SF36 [Leplège 1998] and s specific questionnaire, the French version of the EORTC QLQ-C30. EORTC QLQ-C30

Source: https://euclinicaltrials.eu/ctis-public/view/2024-515432-71-00